EU clinical trial 2023-509727-40-00: Burning mouth syndrome: A novel treatment
Sponsor: Malmoe Universitet (Educational Institution). Phase: Therapeutic exploratory (Phase II). Countries: Sweden (ongoing, recruiting).
Therapeutic area(s): Diseases [C] - Stomatognathic Diseases [C07]
Gender: Female, Male. Age: 18-64 years, 65+ years. Enrolment: 30.
Status: Ongoing, recruiting. Start date (EU): 2025-06-16. Decision date: 2024-04-22. Results received: No. Last updated: 2024-04-22.

Condition(s): Burning mouth syndrome
Product: CLONAZEPAM

Primary endpoint: Pain intensity [ Time Frame: will be assessed immediately before start of treatment as well as one, two and three weeks after treatment start ] Overall oral mucosa pain intensity. Will be assessed using the subscale "Characteristic pain intensity" (three numerical rating scales 0 - 10 assessing current pain. intensity as well as worst and average pain intensity during the last two weeks) in the Graded Chronic Pain Scale, Patient global impression of change (PGIC), Pain related disability
Endpoint(s): Somatosensory changes including taste changes, Jaw function limitation using JFLS-20, Stress using PSS-10, Pain catastrophizing using PCS

Source: https://euclinicaltrials.eu/ctis-public/view/2023-509727-40-00